EU clinical trial 2023-503894-39-00: Prospective Randomized trial of Everolimus replacing MMF/MP Acid by the RECOVAC consortium to increase VACcine response in kidney transplant patients
Protocol code: 11442
Sponsor: Universitair Medisch Centrum Groningen (Hospital/Clinic/Other health care facility). Phase: Phase III and phase IV (Integrated). Countries: Netherlands (ended).
Therapeutic area(s): Diseases [C] - Immune System Diseases [C20]; Analytical, Diagnostic and Therapeutic Techniques and Equipment [E] - Therapeutics [E02]; Diseases [C] - Virus Diseases [C02]
Gender: Female, Male. Age: 18-64 years, 65+ years. Enrolment: 110.
Status: Ended. Start date (EU): 2023-08-22. End date (EU): 2024-02-27. Decision date: 2023-06-01. Results received: Yes. Last updated: 2023-10-10.

Condition(s): kidney transplantation, COVID-19, Herpes Zoster, impaired immunity
Product: CellCept 1 g/5 ml powder for oral suspension, Certican 0,25, tabletten 0,25 mg, CellCept 250 mg capsules, Myfortic 360 mg, maagsapresistente tablet, Shingrix powder and suspension for suspension for injection Herpes zoster vaccine (recombinant, adjuvanted), CellCept 500 mg film-coated tablets, Certican 0,5, tabletten 0,5 mg, Certican 1,0, tabletten 1,0 mg, Certican 0,75, tabletten 0,75 mg, Myfortic 180 mg, maagsapresistente tablet, Comirnaty Omicron XBB.1.5 30 micrograms/dose dispersion for injection COVID-19 mRNA Vaccine (nucleoside modified)

Primary endpoint: The neutralizing antibody titer against the Omicron XBB.1.5 strain 28 days after monovalent Omicron XBB.1.5. COVID-19 vaccination in patients continuing MMF/MPA compared to patients who switched to everolimus.
Endpoint(s): SARS-CoV-2 specific anti-S1 antibody level at 28 days after COVID-19 vaccination, Varicella zoster specific anti-gE antibody level 28 days after 1st and 2nd herpes zoster vaccination, SARS-CoV-2 specific T-cell response at 28 days after COVID-19 vaccination, Varicella zoster specific T-cell response at 28 days after 2nd herpes zoster vaccination, Incidence of treated acute rejection, Change in estimated glomerular filtration rate and proteinuria during the study, Incidence of serious adverse events throughout the study, Incidence of adverse events of special interest throughout the study, Incidence of dnDSAs at V7, or when not participating in second part of the study at V5., Incidence of solicited adverse events of COVID-19 vaccination during 7 days after vaccination, Incidence of solicited adverse events of herpes zoster vaccination during 7 days after each vaccination

Source: https://euclinicaltrials.eu/ctis-public/view/2023-503894-39-00